EU clinical trial 2024-511101-28-00: A multicentre, randomised, double-blind, placebo-controlled, dose escalation and dose finding phase II study to evaluate the safety and efficacy of IPN10200 in the prevention of episodic or chronic migraine in adults
Protocol code: CLIN-10200-454
Sponsor: Ipsen Innovation (Pharmaceutical company). Phase: Therapeutic exploratory (Phase II). Countries: Germany (ongoing, recruitment ended), France (ongoing, recruitment ended), Czechia (ongoing, recruitment ended), Spain (ongoing, recruitment ended), Poland (ongoing, recruitment ended).
Therapeutic area(s): Diseases [C] - Nervous System Diseases [C10]
Gender: Female, Male. Age: 18-64 years, 65+ years. Enrolment: 311.
Status: Ongoing, recruitment ended. Start date (EU): 2026-02-24. Decision date: 2025-07-10. Results received: No. Last updated: 2026-07-30.
Decision dates by country: FR: 2025-07-11, DE: 2025-07-10, ES: 2025-07-16, PL: 2025-07-18, CZ: 2025-07-15

Condition(s): Episodic Migraine Chronic Migraine
Product: IPN10200, IPN10200 placebo

Primary endpoint: Percentage of participants experiencing any Adverse Event (AEs) including treatment emergent adverse events (TEAEs), serious adverse events (SAEs), adverse event of special interest (AESI) and AE leading to treatment discontinuation [ Time Frame: For step 1: From baseline until end of study at Week 36 ], Percentage of Participants with clinically significant changes from baseline in Laboratory Parameters [ Time Frame: For step 1: At all timepoints post injection until Week 36 ] Clinically significant change in laboratory parameters will be reported. The clinical significance will graded by the investigator., Percentage of Participants With Clinically Significant Changes from baseline in Vital Signs [ Time Frame: For step 1: At all timepoints post injection until Week 36 ] Clinically significant changes in vital signs will be reported. The clinical significance will be graded by the investigator., Percentage of participants with clinically significant change from baseline in facial examination [ Time Frame: For step 1: At all timepoints post injection until Week 36 ] Clinically significant changes in facial examination and focused neurological/physical examinations will be reported. The clinical significance will be graded by the investigator., Percentage of participants with clinically significant change from baseline in 12-lead Electrocardiogram (ECG) readings [ Time Frame: For step 1: At all timepoints post injection until Week 36 ], Treatment-emergence of suicidal ideation/suicidal behaviour [ Time Frame: For step 1: At all timepoints post injection until Week 36 ], Percentage of participants with Binding antibodies to IPN10200 [ Time Frame: For step 1: At baseline, Week 4, Week 12 and Week 36. ], Percentage of participants with neutralising antibodies to IPN10200 [ Time Frame: For step 1: At baseline, Week 4, Week 12 and Week 36. ], Change from baseline in the number of Monthly migraine days (MMD)s [ Time Frame: For step 2: At Week 12 (Weeks 9-12). ]
Endpoint(s): Change from baseline in the number of MMD [ Time Frame: For Step 1 and step 2: From Week 1 to Week 36. ], Change from baseline in the number of Monthly Headache Days (MHD) [ Time Frame: For Step 1 and step 2: From Week 1 to Week 36 ], Change from baseline in the number of moderate/severe MHD [ Time Frame: For Step 1 and step 2: From Week 1 to Week 36 ], Migraine prevention response [ Time Frame: For Step 1 and step 2: From Week 1 to Week 36 ] Migraine prevention response is assessed using two thresholds: by a reduction from baseline of either ≥50% or ≥75% in MMD, Headache prevention response [ Time Frame: For Step 1 and step 2: From Week 1 to Week 36. ] Assessed using two thresholds: by a reduction from baseline of either ≥50% or ≥ 75% in MHD, Change from baseline in the number of days per 4 week period of acute medication use for migraine relief. [ Time Frame: For Step 1 and step 2: From Week 1 to Week 36. ] An acute medication use day is defined as any day on which a participant reports, per eDiary, the intake of allowed medication(s) for the acute treatment of migraine., The use of acute migraine medication (yes or no) [ Time Frame: For Step 1 and step 2: From Week 1 to Week 36. ] The use of acute migraine medication will be recorded in the daily eDiary., Percentage of participants with Binding antibodies to IPN10200 [ Time Frame: For step 2 : At baseline, Week 4, Week 12 , Week 24 and Week 36. ], Percentage of participants with neutralising antibodies to IPN10200 [ Time Frame: For step 2 : At baseline, Week 4, Week 12 , Week 24 and Week 36. ]

Source: https://euclinicaltrials.eu/ctis-public/view/2024-511101-28-00